EU clinical trial 2025-521293-34-00: A Seamless Phase 2a/2b, Randomized, Double-Blind, Placebo- and Active-Controlled, Multiple-Arm, Multiple-Stage, Adaptive Study Evaluating the Efficacy and Safety of LAD191 in Adults With Moderate-to-Severe Hidradenitis Suppurativa
Protocol code: M-27134-10
Sponsor: Almirall S.A. (Pharmaceutical company). Phase: Therapeutic exploratory (Phase II). Countries: Germany (ongoing, recruitment ended), Italy (authorised, recruiting), Ireland (ongoing, recruitment ended), Poland (ongoing, recruitment ended), Spain (ongoing, recruitment ended), France (authorised, recruiting).
Therapeutic area(s): Diseases [C] - Skin and Connective Tissue Diseases [C17]
Gender: Female, Male. Age: 18-64 years. Enrolment: 128.
Start date (EU): 2025-12-09. Decision date: 2025-11-03. Results received: No. Last updated: 2026-05-27.
Decision dates by country: FR: 2025-11-03, IE: 2025-11-07, IT: 2025-11-04, ES: 2025-11-05, PL: 2025-11-07, DE: 2025-11-06

Condition(s): Moderate-to-severe hidradenitis suppurativa
Product: SODIUM CHLORIDE, ADALIMUMAB, LAD191, LAD191 placebo

Primary endpoint: Proportion of participants achieving HiSCR 50, Safety endpoint: Frequency and severity of treatment-emergent AEs, SAEs, AEs leading to discontinuation, and AESIs, Safety endpoint: Local tolerance, vital signs, ECGs, and clinical laboratory parameters

Source: https://euclinicaltrials.eu/ctis-public/view/2025-521293-34-00